EU clinical trial 2023-509654-60-00: A Phase 1/2a Study Evaluating the Effects of ARO-RAGE Inhalation Solution in Healthy Subjects and Patients with Inflammatory Lung Disease
Protocol code: ARORAGE-1001
Sponsor: Arrowhead Pharmaceuticals Inc. (Pharmaceutical company). Phase: Phase I and Phase II (Integrated)- Other. Countries: Poland (ended), Spain (ended).
Therapeutic area(s): Diseases [C] - Respiratory Tract Diseases [C08]
Gender: Female, Male. Age: 18-64 years, 65+ years. Enrolment: 42.
Status: Ended. Start date (EU): 2023-06-21. End date (EU): 2025-04-16. End date: 2025-04-17. Decision date: 2024-07-05. Results received: Yes. Last updated: 2024-12-12.
Decision dates by country: PL: 2024-07-09, ES: 2024-07-05

Condition(s): Inflammatory Lung Disease
Product: 0.9% Sodium chloride - inhalation solution

Primary endpoint: The incidence and frequency of treatment-emergent adverse events (TEAEs) over time through end of study (EOS)
Endpoint(s): 1. Change from baseline over time through EOS in forced expiratory volume (FEV1) as a safety assessment, 2. Change from baseline over time through EOS in forced vital capacity (FVC) as a safety assessment, 3. Change from baseline over time through EOS in diffusing capacity for carbon monoxide (DLCO) as a safety assessment, 4. Plasma PK parameters of ARO-RAGE after each dose of study drug

Source: https://euclinicaltrials.eu/ctis-public/view/2023-509654-60-00